EU clinical trial 2025-520517-32-00: Investigate Drug-Drug Interactions between LVDS (Levonorgestrel Vaginal Delivery System) and Tampons and Lubricants in Healthy Female Participants
Protocol code: LR-104
Sponsor: Chemo Research S.L. (Pharmaceutical company). Phase: Human Pharmacology (Phase I)- Other. Countries: Portugal (ended).
Therapeutic area(s): Not possible to specify
Gender: Female. Age: 18-64 years. Enrolment: 20.
Status: Ended. Start date (EU): 2025-05-29. End date (EU): 2025-10-15. Decision date: 2025-05-08. Results received: No. Last updated: 2025-07-01.

Condition(s): No medical condition.

Source: https://euclinicaltrials.eu/ctis-public/view/2025-520517-32-00